EU clinical trial 2025-524035-39-00: Single dose, open-label, laboratory blinded, randomized, 2-treatment, 2-period, 2-sequence, crossover, pivotal study to assess the relative bioavailability of Test Product Naproxen sodium 660 mg modified release tablets to Reference Product Actromadol 660 mg Modified-Release tablets in healthy adult male and female subjects under fasting conditions.s.
Protocol code: 1062/25
Sponsor: Laboratorios Cinfa S.A. (Pharmaceutical company). Phase: Human Pharmacology (Phase I)- Bioequivalence Study. Countries: Czechia (ended).
Therapeutic area(s): Not possible to specify
Gender: Female, Male. Age: 18-64 years. Enrolment: 32.
Status: Ended. Start date (EU): 2026-01-14. End date (EU): 2026-02-03. Decision date: 2025-12-09. Results received: No. Last updated: 2025-12-15.
Decision dates by country: CZ: 2025-12-15

Condition(s): Bioavailability study in healthy volunteers under fasting conditions.

Source: https://euclinicaltrials.eu/ctis-public/view/2025-524035-39-00